EU clinical trial 2024-516974-31-00: Phase II Clinical Trial to optimize the dose of an anti-NKG2A monoclonal antibody (humZ270 mAb, IPH2201) for patients with acute myeloid leukemia or myelodysplastic syndrome undergoing haploidentical transplantation with post-transplantation cyclophosphamide.
Protocol code: ONC-2020-001
Sponsor: Humanitas Mirasole S.p.A. (Hospital/Clinic/Other health care facility). Phase: Therapeutic exploratory (Phase II). Countries: Italy (ongoing, recruiting).
Therapeutic area(s): Diseases [C] - Hemic and Lymphatic Diseases [C15]
Gender: Female, Male. Age: 18-64 years, 65+ years. Enrolment: 42.
Status: Ongoing, recruiting. Start date (EU): 2022-07-22. Decision date: 2024-10-07. Results received: No. Last updated: 2026-06-15.

Condition(s): Patients with acute myeloid leukemia or myelodysplastic syndrome.
Product: Monalizumab

Primary endpoint: To evaluate the efficacy and safety of NKG2A blockade by Monalizumab after Haplo-SCT with PTCy in terms of GPFS.
Endpoint(s): Clinical Objectives: Evaluate the incidence of OS, PFS, NRM and post-transplant viral infections in patients receiving Monalizumab after Haplo-SCT., Biological Objectives: Evaluate the reconstitution and alloreactive functions of NK cell population against leukemic cells after Monalizumab administration.

Source: https://euclinicaltrials.eu/ctis-public/view/2024-516974-31-00